EU clinical trial 2024-512196-12-00: A randomized, placebo-controlled, double-blind, single-ascending-dose, Phase 1a/b study to assess the safety, pharmacokinetics, pharmacodynamics, and immunogenicity of intravenous NTR-641 in healthy adults and patients with acute ischemic stroke
Protocol code: NTR641-01
Sponsor: Neutrolis Inc. (Pharmaceutical company). Phase: Human Pharmacology (Phase I)- First administration to humans. Countries: Austria (authorised, recruitment pending).
Therapeutic area(s): Diseases [C] - Cardiovascular Diseases [C14]
Gender: Female, Male. Age: 18-64 years, 65+ years. Enrolment: 72.
Status: Authorised, recruitment pending. Decision date: 2024-12-02. Results received: No. Last updated: 2025-07-21.

Condition(s): Acute Ischemic Stroke

Source: https://euclinicaltrials.eu/ctis-public/view/2024-512196-12-00